EU clinical trial 2024-513754-29-00: A Phase 3 Study Evaluating the Pharmacokinetics, Safety, and Tolerability of VX 121/Tezacaftor/Deutivacaftor Triple Combination Therapy in Cystic Fibrosis Subjects 1 Through 11 Years of Age (VX21-121-105)
Protocol code: VX21-121-105
Sponsor: Vertex Pharmaceuticals Inc. (Pharmaceutical company). Phase: Therapeutic confirmatory (Phase III). Countries: France (ongoing, recruiting), Germany (ongoing, recruiting), Sweden (ongoing, recruiting), Netherlands (ongoing, recruiting), Belgium (authorised, recruitment pending), Denmark (authorised, recruitment pending), Ireland (authorised, recruitment pending).
Therapeutic area(s): Diseases [C] - Respiratory Tract Diseases [C08]
Gender: Female, Male. Age: 0-17 years. Enrolment: 23.
Start date (EU): 2023-03-06. Decision date: 2024-09-20. Results received: No. Last updated: 2026-07-06.
Decision dates by country: NL: 2024-09-20, FR: 2024-09-24, DE: 2024-09-20, SE: 2024-09-20, BE: 2026-06-11, DK: 2026-06-23, IE: 2026-07-06

Condition(s): Cystic Fibrosis
Product: VX-121/VX-661/VX-561 Film-coated tablet, VX-445/VX-661/VX-770 film-coated fixed-dose combination tablet, VX-445/VX-661/VX-770 fixed-dose combination granules, VX-121/VX-661/VX-561 granules, Kalydeco 75 mg granules in sachet, VX-121/VX-661/VX-561 Film-coated tablet, Kalydeco 150 mg film-coated tablets, VX-445/VX-661/VX-770 fixed-dose combination granules, Kalydeco 59.5 mg granules in sachet, VX-445/VX-661/VX-770 fixed-dose combination tablet, Kaftrio 37.5 mg/25 mg/50 mg film-coated tablets, VX-121/VX-661/VX-561 granules, Kalydeco 75 mg film-coated tablets

Primary endpoint: Part A: PK parameters of VX-121, TEZ, D-IVA, and relevant metabolites, Part A: Safety and tolerability as determined by adverse events (AEs), clinical laboratory values, standard 12 lead ECGs, vital signs, and pulse oximetry, Part B: Safety and tolerability as determined by AEs, clinical laboratory values, standard 12-lead ECGs, vital signs, and pulse oximetry
Endpoint(s): Part B (ID 1-11): Absolute change in SwCl from baseline through Week 24, PK parameters of VX 121, TEZ, D-IVA, and relevant metabolites, Drug acceptability assessment using Modified Facial Hedonic Scale, Absolute change in ppFEV1 from baseline through Week 24, Number of PEx and CF-related hospitalizations through Week 24, Absolute change in CFQ-R RD score from baseline through Week 24, Absolute change in BMI and BMI-for-age z-score from baseline at Week 24, Absolute change in weight and weight-for-age z-score from baseline at Week 24, Absolute change in height and height-for-age z-score from baseline at Week 24, Proportion of subjects with SwCl <60 mmol/L through Week 24, Proportion of subjects with SwCl <30 mmol/L through Week 24

Source: https://euclinicaltrials.eu/ctis-public/view/2024-513754-29-00